EU clinical trial 2024-512382-13-00: C4951009: A Phase 3, Randomized, Double-blind, Placebo-controlled Study to Evaluate the Efficacy and Safety of Rimegepant in Migraine Prevention in Children and Adolescents ≥ 6 to <18 years of age
Protocol code: C4951009
Sponsor: Pfizer Inc. (Pharmaceutical company). Phase: Therapeutic confirmatory (Phase III). Countries: France (ongoing, recruiting), Italy (ongoing, recruiting), Spain (ongoing, recruiting), Poland (ongoing, recruiting).
Therapeutic area(s): Diseases [C] - Nervous System Diseases [C10]
Gender: Female, Male. Age: 0-17 years. Enrolment: 415.
Status: Ongoing, recruiting. Start date (EU): 2022-10-04. Decision date: 2024-07-23. Results received: No. Last updated: 2026-05-20.
Decision dates by country: FR: 2024-07-29, ES: 2024-07-23, IT: 2024-07-29, PL: 2024-07-24

Condition(s): Migraine (with or without aura)
Product: Rimegepant Placebo, VYDURA 75 mg oral lyophilisate, 35 mg oral lyophilisate, 25 mg oral lyophilisate, 50 mg oral lyophilisate

Primary endpoint: Mean change from baseline (observation period, OP) in the number of migraine days per month over the entire DBT phase (Weeks 1 to 12) in adolescents with episodic migraine.
Endpoint(s): Percentage of participants with ≥50% reduction from the OP in the number of moderate to severe migraine days per month over the entire DBT phase in adolescents with episodic migraine., Mean change from the OP in the number of moderate to severe headache days per month over the entire DBT phase in adolescents with episodic migraine., Mean change from the OP in the number of migraine days per month in the first 4 weeks (Weeks 1 to 4) of the DBT phase in adolescents with episodic migraine., Mean change from baseline in the Pediatric Quality of Life (PedsQLTM) total score at Week 12 of the DBT phase in adolescents with episodic migraine.

Source: https://euclinicaltrials.eu/ctis-public/view/2024-512382-13-00